EU clinical trial 2024-511151-18-01: Takeda Brentuximab; Molecular Imaging of Zirconium-89-labeled Brentuximab as a Tool to Investigate brentuximab biodistribution in CD30-positive Lymphoma
Protocol code: NL202100762
Sponsor: Universitair Medisch Centrum Groningen (Hospital/Clinic/Other health care facility). Phase: Human Pharmacology (Phase I)- Other. Countries: Netherlands (ongoing, recruiting).
Therapeutic area(s): Diseases [C] - Hemic and Lymphatic Diseases [C15]
Gender: Female, Male. Age: 18-64 years, 65+ years. Enrolment: 20.
Status: Ongoing, recruiting. Start date (EU): 2025-01-02. Decision date: 2024-11-25. Results received: No. Last updated: 2024-11-25.

Condition(s): Patients with stage II-IV high risk diffuse large B-cell lymphoma, defined as international prognostic index > 2, Lymphoma

Source: https://euclinicaltrials.eu/ctis-public/view/2024-511151-18-01